EU clinical trial 2022-502128-38-00: Effisayil® REP: An open-label, multicenter, single-arm, post-marketing trial (in select countries) to evaluate efficacy and safety and the impact of immunogenicity on efficacy, safety, and pharmacokinetics of spesolimab i.v. in treatment of patients with Generalized Pustular Psoriasis (GPP) presenting with a recurrent flare following their initial GPP flare treatment with spesolimab i.v.
Protocol code: 1368-0120
Sponsor: Leo Pharma A/S (Pharmaceutical company). Phase: Phase III and phase IV (Integrated). Countries: France (ended), Germany (ongoing, recruitment ended), Italy (ended), Spain (ended), Belgium (ended).
Therapeutic area(s): Diseases [C] - Skin and Connective Tissue Diseases [C17]
Gender: Female, Male. Age: 18-64 years, 65+ years. Enrolment: 7.
Start date (EU): 2023-10-11. Decision date: 2023-10-04. Results received: No. Last updated: 2026-07-14.
Decision dates by country: IT: 2023-10-05, BE: 2023-10-06, DE: 2023-10-04, ES: 2023-10-06, FR: 2023-10-04

Condition(s): Generalized Pustular Psoriasis

Primary endpoint: Achievement of a GPPGA pustulation subscore of 0 indicating no visible pustules at Week 1
Endpoint(s): Achievement of a GPPGA pustulation subscore of 0 or 1, with a ≥2-point reduction from baseline at Week 1. The baseline is the last measurement prior to the first dose of re-treatment with spesolimab i.v.

Source: https://euclinicaltrials.eu/ctis-public/view/2022-502128-38-00